EU clinical trial 2024-515776-12-00: Epirubicin for the Treatment of Sepsis & Septic Shock
Protocol code: EPOS_ZKSJ0134
Sponsor: Friedrich-Schiller-Universitaet Jena (Educational Institution). Phase: Therapeutic exploratory (Phase II). Countries: Germany (ended).
Therapeutic area(s): Diseases [C] - Bacterial Infections and Mycoses [C01]
Gender: Female, Male. Age: 18-64 years, 65+ years. Enrolment: 45.
Status: Ended. Start date (EU): 2022-06-30. End date (EU): 2025-05-21. Decision date: 2024-10-01. Results received: No. Last updated: 2024-10-01.

Condition(s): Patients with sepsis or septic shock, currently hospitalized at the Intensive Care Unit (ICU) or Intermediate Care (IMC) regardless where the sepsis was first diagnosed.
Product: Epirubicin 50 mg HEXAL® Injektionslösung, 2 mg/ml, Isotonische Kochsalzlösung Fresenius

Primary endpoint: Safety as assessed by myelotoxicity until day 14 is the primary endpoint.
Endpoint(s): Degree of organ dysfunction measured by SOFA score., Occurrence of Adverse Events., Occurrence of Cardiotoxicity., Survival at day 14, 28 and 90., SOFA “Success” rate defined as a decrease of procalcitonin (PCT) serum concentration by 80% or more of its intra-individual peak value or to 0.5 μg/L or lower within 72 hours after randomization.

Source: https://euclinicaltrials.eu/ctis-public/view/2024-515776-12-00